EU clinical trial 2024-517797-14-00: A Study to Learn About if the Study Medicine Called Ibuzatrelvir changes how the body process the other Medicine Dabigatran Etexilate in healthy adults
Protocol code: C5091010
Sponsor: Pfizer Inc. (Pharmaceutical company). Phase: Human Pharmacology (Phase I)- Other. Countries: Belgium (ended).
Therapeutic area(s): Diseases [C] - Virus Diseases [C02]
Gender: Female, Male. Age: 18-64 years, 65+ years. Enrolment: 20.
Status: Ended. Start date (EU): 2024-11-19. End date (EU): 2025-01-15. End date: 2025-01-16. Decision date: 2024-11-19. Results received: No. Last updated: 2025-01-15.
Decision dates by country: BE: 2025-01-15

Condition(s): severe acute respiratory syndrome coronavirus 2 (SARS-CoV-2)

Source: https://euclinicaltrials.eu/ctis-public/view/2024-517797-14-00